EU clinical trial 2023-507377-17-00: A Phase 1b, Randomized, Open-Label Trial to Evaluate Safety, Engraftment, and Initial Signs of Clinical Activity of MB097 in Combination with Pembrolizumab in Melanoma Patients with Primary Resistance to an Anti-PD-1-Containing Immunotherapy (MELODY-1)
Protocol code: MB097-01
Sponsor: Microbiotica Limited (Pharmaceutical company). Phase: Human Pharmacology (Phase I)- First administration to humans. Countries: Spain (ongoing, recruitment ended), France (ongoing, recruitment ended), Italy (ongoing, recruitment ended).
Therapeutic area(s): Diseases [C] - Skin and Connective Tissue Diseases [C17]; Diseases [C] - Neoplasms [C04]
Gender: Female, Male. Age: 18-64 years, 65+ years. Enrolment: 27.
Status: Ongoing, recruitment ended. Start date (EU): 2024-08-28. Decision date: 2024-07-22. Results received: No. Last updated: 2026-04-22.
Decision dates by country: IT: 2024-07-24, FR: 2024-09-09, ES: 2024-07-26

Condition(s): Advanced Melanoma

Source: https://euclinicaltrials.eu/ctis-public/view/2023-507377-17-00